EU clinical trial 2024-512078-88-00: A Study of Glucothera Plus for Peritoneal Dialysis in Children (ASTRA)
Protocol code: IP-001-21
Sponsor: Iperboreal Pharma S.r.l. (Pharmaceutical company). Phase: Therapeutic confirmatory (Phase III). Countries: Italy (temporarily halted).
Therapeutic area(s): Diseases [C] - Female Urogenital Diseases and Pregnancy Complications [C13]; Diseases [C] - Male Urogenital Diseases [C12]
Gender: Female, Male. Age: 0-17 years. Enrolment: 20.
Status: Temporarily halted. Start date (EU): 2024-04-29. Decision date: 2024-04-08. Results received: No. Last updated: 2024-04-08.

Condition(s): End-stage Kidney Disease
Product: GLUCOTHERA PLUS

Primary endpoint: Safety assesses on the basis of continuous Adverse Events reporting, including evaluation of blood pressure and weight
Endpoint(s): Kt/V urea (V2 and V3), 24h Peritoneal ultrafiltration (V2 and V3), 24h urinary volume (V2 and V3), Peritoneal Equilibration Test (V2 and V3), Residual Kidney Function (V2 and V3), Plasma L-carnitine (V1, V2 and V3), Tolerability assessment - blood chemistry and hematology (V2, V3, V4)

Source: https://euclinicaltrials.eu/ctis-public/view/2024-512078-88-00